EU clinical trial 2023-503557-35-00: Randomised, crossover bioequivalence clinical trial of apixaban 5 mg film-coated tablets, after a single oral dose administration to healthy volunteers under fasting conditions
Protocol code: UECHUP-API/23-1
Sponsor: Alter Farmacia S.A. (Pharmaceutical company). Phase: Human Pharmacology (Phase I)- Bioequivalence Study. Countries: Spain (ended).
Therapeutic area(s): Diseases [C] - Cardiovascular Diseases [C14]
Gender: Female, Male. Age: 18-64 years. Enrolment: 24.
Status: Ended. Start date (EU): 2023-06-08. End date (EU): 2023-07-07. Decision date: 2023-06-02. Results received: Yes. Last updated: 2023-06-02.

Condition(s): thromboembolism
Product: Eliquis 5 mg film-coated tablets, APIXABAN

Primary endpoint: AUC0-t and Cmax of apixaban
Endpoint(s): AUC0-∞, Tmax and residual area of apixaban.

Source: https://euclinicaltrials.eu/ctis-public/view/2023-503557-35-00